EU clinical trial 2023-503241-63-00: A Phase 2/3 randomized controlled semi-blinded trial to investigate safety and effectiveness in visualization of the ureters with nizaracianine triflutate, administered intravenously in up to three divided doses, in participants (18 years or older) undergoing abdominopelvic surgical procedures [TRIPHASE Trial].
Protocol code: ZW800-001
Sponsor: Curadel Surgical Innovations Inc., Curadel Surgical Innovations B.V. (Pharmaceutical company). Phase: Phase II and Phase III (Integrated). Countries: Netherlands (ongoing, recruiting).
Therapeutic area(s): Analytical,Diagnostic,Therapeutic Techniques and Equipment [E]-Surgical Procedures, Operative [E04]
Gender: Female, Male. Age: 18-64 years, 65+ years. Enrolment: 168.
Status: Ongoing, recruiting. Start date (EU): 2024-05-21. Decision date: 2023-11-23. Results received: No. Last updated: 2026-06-30.

Condition(s): Urinary tract imaging
Product: nizaracianine triflutate, Glucose 5 %, oplossing voor infusie 50 g/l

Primary endpoint: Phase 2: Determination of the near-optimal dose in the context of an acceptable safety profile, Phase 2 and 3: Safety assessment, Phase 2 and 3: The proportion of subjects for whom the surgeon is able to successfully identify the required length of the ureters (specified prior to surgery by the surgeon) with a peak SBR ≥ 1.5
Endpoint(s): i. Proportion of cases in which ureter identification did not require invasive procedures or dissection of surrounding tissue, ii. Average time required for initial ureter identification (minutes), iii. Proportion of cases for which ureter integrity status (leak vs. no leak) and function (flow/obstructions) were determined at closing without the need for invasive procedures and/or tissue manipulation, iv. Among cases that normally require ureter skeletonization/ureter dissection, the proportion of cases where skeletonization/ureter dissection could be reduced or eliminated, v. Average time period of ureter visualization provided by the first dose of nizaracianine, vi. Average dose interval and average number of doses of nizaracianine preferred by surgeons for optimal visualization of the ureters during surgeries of various lengths (Phase 3 only), vii. Among subjects with ureter injury, the proportion of cases detected intraoperatively, viii. Among subjects with intraoperative detection of ureter injury, the proportion of cases in which nizaracianine assisted repair, ix. For a particular surgical procedure type, average overall surgery time (Phase 3A only), Exploratory endpoint: i. In bladder-involved cases, the proportion of cases where nizaracianine helped identify bladder anatomy, Exlporatory endpoint: ii. The proportion of cases where nizaracianine provided NIR fluorescence enhancement of blood vessels in the surgical field

Source: https://euclinicaltrials.eu/ctis-public/view/2023-503241-63-00